EU clinical trial 2023-505788-35-00: Complex immunomodulatory therapy for patients with immune thrombocytopenia (T-MEM)
Sponsor: Fakultni Nemocnice Hradec Kralove (Hospital/Clinic/Other health care facility). Phase: Therapeutic exploratory (Phase II). Countries: Czechia (ongoing, recruiting).
Therapeutic area(s): Diseases [C] - Immune System Diseases [C20]; Diseases [C] - Hemic and Lymphatic Diseases [C15]
Gender: Female, Male. Age: 18-64 years, 65+ years. Enrolment: 50.
Status: Ongoing, recruiting. Start date (EU): 2025-06-11. Decision date: 2023-06-22. Results received: No. Last updated: 2025-05-29.

Condition(s): Immune thrombocytopenia
Product: Nplate 250 micrograms powder for solution for injection, Nplate 250 micrograms powder for solution for injection, Revolade 50 mg film-coated tablets, CICLOSPORIN, RITUXIMAB, Doptelet 20 mg film-coated tablets, MYCOPHENOLATE MOFETIL, Revolade 50 mg film-coated tablets, Doptelet 20 mg film-coated tablets, Revolade 50 mg film-coated tablets, Doptelet 20 mg film-coated tablets

Primary endpoint: Platelets count at visit M3, M7, M12 and M18,, Number of patients in remission without the need for therapy at visit M7, M12, M18
Endpoint(s): The number of relapses within 12 months of the end of therapy, The number of patients who complete the entire cycle, The results of the standardized SF-36 quality of life questionnaire before starting, during and after treatment, Biomarker levels (kynurenine, neopterin, tryptophan) and their changes in connection with treatment, values of CD4+/CD8+ T lymphocytes and their cytokine production (IL-4, IL-17A, IFNγ), regulatory CD4+ T lymphocytes and anti-platelet antibodies as possible predictive parameters of response to therapy

Source: https://euclinicaltrials.eu/ctis-public/view/2023-505788-35-00